EU clinical trial 2022-503044-40-00: Preoperative immunotherapy with atezolizumab (Tecentriq®) and tiragolumab or atezolizumab (Tecentriq®) and bevacizumab (Avastin®) in patients with colorectal liver metastases (CRLM) (the PURPLE trial)
Protocol code: PURPLE
Sponsor: Universitaetsklinikum Essen AöR (Hospital/Clinic/Other health care facility). Phase: Therapeutic exploratory (Phase II). Countries: Germany (ongoing, recruiting).
Therapeutic area(s): Diseases [C] - Neoplasms [C04]
Gender: Female, Male. Age: 18-64 years, 65+ years. Enrolment: 18.
Status: Ongoing, recruiting. Start date (EU): 2026-06-26. Decision date: 2024-08-15. Results received: No. Last updated: 2026-03-17.

Condition(s): Colorectal liver metastases (CRLM)
Product: Tecentriq 840 mg concentrate for solution for infusion, Tecentriq 840 mg concentrate for solution for infusion, Tecentriq 840 mg concentrate for solution for infusion, Avastin 25 mg/ml concentrate for solution for infusion., Tecentriq 840 mg concentrate for solution for infusion

Primary endpoint: Percentage of resected patients with complete or major pathological regression
Endpoint(s): Percentage of patients who underwent surgery after preoperative IO therapy, Incidence, relatedness and severity of adverse events occurring during preoperative short time immunotherapy within 90 days of surgery (Severity for all events will be graded according to NCI CTCAE v5.0), Assessment of postoperative complication rates according to the Clavien-Dindo Classification, Mortality within 90 days of surgery, Estimation of curative (R0) resection rate, Assessment of PET response (PET-CT or PET-MRI) after short term immunotherapy, Patients, who do not undergo surgery: Reasons for not having surgery, Percentage of resected patients with complete or major pathological regression as evaluated by independent central review

Source: https://euclinicaltrials.eu/ctis-public/view/2022-503044-40-00